EU clinical trial 2024-517975-19-00: Pulmonary REsistance modification under treatment with Sacubitil/valsartaN in paTients with HeartFailure with reduced ejection fraction
Protocol code: 2019/ABM/01/00078
Sponsor: Uniwersytecki Szpital Kliniczny W Poznaniu (Hospital/Clinic/Other health care facility). Phase: Therapeutic use (Phase IV). Countries: Poland (ended).
Therapeutic area(s): Diseases [C] - Cardiovascular Diseases [C14]
Gender: Female, Male. Age: 18-64 years, 65+ years. Enrolment: 32.
Status: Ended. Start date (EU): 2022-12-12. End date (EU): 2025-07-18. Decision date: 2024-12-18. Results received: No. Last updated: 2026-07-17.

Condition(s): Heart Failure with reduced ejection fraction.
Product: Placebo Enalapril 2,5 mg, Placebo Entresto 24mg/26mg, Entresto 24 mg/26 mg film-coated tablets, Enalapril-ratiopharm® 2,5 mg Tabletten

Primary endpoint: Change from baseline in mean pulmonary artery pressure (mPAP)., Change from baseline in pulmonary vascular resistance (PVR).
Endpoint(s): Change from baseline in pulmonary wedge pressure (PWP)., Change from baseline in the diastolic pressure gradient (DPG; where DPG = diastolic mPAP – mean PWP )., Change in the 6-minute walk test (6MWT) - analysis of changes from the baseline., Evaluation of the parameters of the spiroergometric test (CPET, Cardio-Pulmonary Exercise Test) analysis of changes in relation to the baseline., Assessment of echocardiographic parameters - analysis of changes in relation to the baseline, The incidence of the composite endpoint of MACCEs such as death from all causes, cardiac death, hospitalization due to worsening / decompensation of HF, stroke / transient ischemic attack (TIA), acute coronary syndrome (ACS) , the need for a heart transplant (HT), the need for a left ventricular assist device (LVAD) or biventricular , an unplanned hospitalization or an outpatient visit due to the need to administer intravenous diuretics or requiring an increase in the dose of diuretics >50% base, Hospitalization or an unplanned visit to the Emergency Department or an unplanned outpatient visit related to HF, The need for unplanned intravenous administration of diuretics., Assessment of quality of life will be conducted between 0-52 weeks (QoL indicators - Kansas City Cardiomyopathy Questionnaire (KCCQ-12), WHO (WHOQOL-BREF), SF-36 questionnaire, EQ-5D-3L questionnaire) - change from the baseline, Assessment of the New York Heart Association (NYHA) and the World Health Organization (WHO) functional classes - change from the baseline

Source: https://euclinicaltrials.eu/ctis-public/view/2024-517975-19-00